EU clinical trial 2024-517652-35-00: A Clinical Study to Compare the Impact of Multiple-dose Oral Administration of Macitentan, 10 mg versus 75 mg on Endothelin-1 Clearance, Endothelial Function, and Hemodynamics in Healthy Participants
Protocol code: 67896062PAH1011
Sponsor: Actelion Pharmaceuticals Ltd. (Pharmaceutical company). Phase: Human Pharmacology (Phase I)- Bioequivalence Study. Countries: France (ended).
Therapeutic area(s): Diseases [C] - Cardiovascular Diseases [C14]
Gender: Female, Male. Age: 18-64 years. Enrolment: 20.
Status: Ended. Start date (EU): 2025-04-01. End date (EU): 2026-03-19. Decision date: 2025-01-13. Results received: No. Last updated: 2026-02-04.

Condition(s): Pulmonary Arterial Hypertension

Source: https://euclinicaltrials.eu/ctis-public/view/2024-517652-35-00